EU clinical trial 2026-526334-67-00: C6501003 - A Phase 1, Open-Label, Randomized, Single Dose, Parallel Group Study to Assess Relative Bioavailability of PF-08653945 When Administered Across Different Injection Sites in Adults With Overweight or Obesity
Protocol code: C6501003
Sponsor: Pfizer Inc. (Pharmaceutical company). Phase: Human Pharmacology (Phase I)- Other. Countries: Belgium (ongoing, recruiting).
Therapeutic area(s): Diseases [C] - Nutritional and Metabolic Diseases [C18]
Gender: Female, Male. Age: 0-17 years, 18-64 years, 65+ years. Enrolment: 57.
Status: Ongoing, recruiting. Start date (EU): 2026-07-10. Decision date: 2026-07-01. Results received: No. Last updated: 2026-07-29.
Decision dates by country: BE: 2026-07-29

Condition(s): chronic weight management and other weight-related co-morbidities
Product: PF-08653945

Primary endpoint: AUCinf (if data permit, otherwise AUClast) and Cmax of PF-08653945.
Endpoint(s): Assessment of TEAEs: • Clinical safety laboratory tests, vital signs, 12-lead ECGs, C-SSRS, and PHQ-8.

Source: https://euclinicaltrials.eu/ctis-public/view/2026-526334-67-00